EU clinical trial 2024-516006-32-00: A clinical study of MK-0472 in people with solid tumors (MK-0472-001)
Protocol code: MK-0472-001
Sponsor: Merck Sharp & Dohme LLC (Pharmaceutical company). Phase: Human Pharmacology (Phase I)- First administration to humans. Countries: Spain (ongoing, recruitment ended), Poland (ongoing, recruitment ended).
Therapeutic area(s): Diseases [C] - Neoplasms [C04]
Gender: Female, Male. Age: 18-64 years, 65+ years. Enrolment: 30.
Status: Ongoing, recruitment ended. Start date (EU): 2025-03-11. Decision date: 2025-02-24. Results received: No. Last updated: 2026-06-16.
Decision dates by country: PL: 2025-03-02, ES: 2025-02-24

Condition(s): Malignant Neoplasm - Solid Tumors

Source: https://euclinicaltrials.eu/ctis-public/view/2024-516006-32-00